EU clinical trial 2024-511829-57-00: A Double-Blind, Oral, Placebo-Controlled, Multiple-Dose, Parallel, Randomized Study to Evaluate Efficacy and Safety of Endoxifen in Bipolar I Disorder Patients
Protocol code: 72189812
Sponsor: Intas Pharmaceuticals Limited (Pharmaceutical company). Phase: Therapeutic confirmatory (Phase III). Countries: Romania (ended).
Therapeutic area(s): Psychiatry and Psychology [F] - Mental Disorders [F03]
Gender: Female, Male. Age: 18-64 years, 65+ years. Enrolment: 27.
Status: Ended. End date (EU): 2025-04-02. Decision date: 2024-10-25. Results received: Yes. Last updated: 2025-02-07.

Condition(s): Bipolar I Disorder
Product: Endoxifen, Identical placebo tablets of Endoxifen manufactured by Intas Pharmaceuticals Limited, India. The placebo tablets were manufactured using the same excipients and the manufacturing process of endoxifen tablets. Like endoxifen 8 mg tablets, the placebo tablets are green coloured, round shape, biconvex, enteric coated tablets plain on both sides. The placebo for Endoxifen Tablets 8 mg was manufactured following the same procedure as the drug product without using endoxifen citrate.

Primary endpoint: Mean change from baseline to Day 21 on the YMRS Total Score.
Endpoint(s): Percentage of patients with improvement of ≥ 50% in total YMRS from baseline., Clinical Global Impression-Bipolar (CGI-BP) score at the end of study., Mean change from baseline to the end of treatment (Day 21) in Montgomery-Åsberg Depression Rating Scale (MADRS) total score., Improvement in Clinical Global Impression-Severity of Illness scale (CGI-S) score., Columbia-Suicide Severity Rating Scale (C-SSRS) score at the end of treatment (Day 21)., Percentage of patients needing lorazepam/diazepam for controlling acute agitation/akathisia., Percentage of patients requiring rescue medications and withdrawal from the study., To evaluate trough concentrations of Endoxifen.

Source: https://euclinicaltrials.eu/ctis-public/view/2024-511829-57-00